EU clinical trial 2023-505319-19-00: Brain Injury and Ketamine: a prospective, randomized controlled double blind clinical trial to study the effects of ketamine on therapy intensity level and intracranial pressure in acute brain injury patients.
Protocol code: S60859
Sponsor: UZ Leuven (Hospital/Clinic/Other health care facility). Phase: Phase III and phase IV (Integrated). Countries: Belgium (ongoing, recruiting).
Therapeutic area(s): Analytical, Diagnostic and Therapeutic Techniques and Equipment [E] - Anesthesia and Analgesia [E03]
Gender: Female, Male. Age: 18-64 years, 65+ years. Enrolment: 100.
Status: Ongoing, recruiting. Start date (EU): 2021-09-01. Decision date: 2024-02-21. Results received: No. Last updated: 2026-02-09.

Condition(s): Traumatic brain injury
Product: Ketalar 50 mg/ml solution injectable, 0,9% NaCl

Primary endpoint: Reduction in cumulative daily TIL score., The number of high intracranial pressure episodes defined as an ICP >22 mmHg for >25 minutes
Endpoint(s): The average intracranial pressure (mmHg) per 24h, Total duration of the first episode of sedative treatment (hours), Total duration of the first episode of mechanical ventilation, Total dose of propofol in mg per 24 hours, Total dose of midazolam in mg per 24 hours, Length of stay in the Intensive Care Unit (ICU), Length of stay in the hospital (days), Average daily Richmond agitation and sedation score (RASS) (addendum 2) per hour, Delirium-free days, defined with the Intensive Care Delirium Screening Checklist (ICDSC) or Confusion Assessment Method-ICU (CAM-ICU) every 8 hours (ICDSC), Extended Glasgow Outcome Score (GOSE) at 6 months after the onset of brain injury, The incidence of barbiturate coma, Incidence of decompressive craniectomy, Incidence of Propofol-Related Infusion Syndrome (PRIS)

Source: https://euclinicaltrials.eu/ctis-public/view/2023-505319-19-00